EU clinical trial 2024-515538-34-00: A Phase 2/3, Randomized Study of INBRX-106 Combined With Pembrolizumab Versus Pembrolizumab as First Line Treatment for Patients With Recurrent or Metastatic (R/M) Head and Neck Squamous Cell Carcinoma (HNSCC) Expressing PD-L1 (CPS ≥20) (HexAgon-HN)
Protocol code: INBRX106-01-201
Sponsor: Inhibrx Biosciences Inc. (Pharmaceutical company). Phase: Phase II and Phase III (Integrated). Countries: Poland (ongoing, recruitment ended), Bulgaria (ongoing, recruitment ended), France (ongoing, recruitment ended), Belgium (ongoing, recruitment ended), Italy (ongoing, recruitment ended), Spain (ongoing, recruitment ended), Romania (ongoing, recruitment ended).
Therapeutic area(s): Diseases [C] - Neoplasms [C04]
Gender: Female, Male. Age: 18-64 years, 65+ years. Enrolment: 175.
Status: Ongoing, recruitment ended. Start date (EU): 2025-02-27. Decision date: 2025-01-21. Results received: No. Last updated: 2026-05-11.
Decision dates by country: FR: 2025-01-22, PL: 2025-01-27, RO: 2025-03-07, IT: 2025-01-22, BE: 2025-01-21, ES: 2025-01-22, BG: 2025-01-27

Condition(s): Head and Neck Squamous Cell Carcinoma
Product: Commercially available 0,9 % sterile saline solution with marketing authorization will be utilized as the placebo., KEYTRUDA 25 mg/mL concentrate for solution for infusion, INBRX-106, INBRX-106

Primary endpoint: ORR, defined as the proportion of patients with a CR or PR on 2 consecutive occasions ≥4 weeks apart, as determined by the Investigator according to RECIST v1.1., PFS, defined as the time from randomization to first occurrence of PD, as determined by the Investigator according to RECIST v1.1, or death from any cause (whichever occurs first)., OS, defined as the time from randomization to death from any cause.
Endpoint(s): DOR, defined as the time from the first occurrence of a documented objective response to PD, as determined by the Investigator according to RECIST v1.1, or death from any cause (whichever occurs first)., CBR, defined as the proportion of patients with SD for ≥12 weeks or a CR or PR, as determined by the Investigator according to RECIST v1.1., PFS rate at 6 months, defined as the proportion of patients who are progression-free and alive 6 months after randomization., Incidence and severity of TEAEs (NCI CTCAE v5.0)., Incidence of dose interruptions and treatment discontinuation., Change from baseline in select vital signs and clinical laboratory parameters., ORR, defined as above., PFS rate at 12 months, defined as above., OS rate at 12 and 24 months, defined as the proportion of patients who are alive 12 and 24 months after randomization., TTCtx, defined as the time from randomization until the start date of chemotherapy or death from any cause (whichever occurs first)., TTCD in pain presence and interference, defined as the time from randomization to the first documentation of a ≥10-point increase from baseline in the EORTC QLQ-C30 pain domain linearly transformed pain scale score held for 2 consecutive timepoints, or a ≥10-point increase followed by death attributable to cancer progression with 28 days from the last assessment., TTCD in physical functioning (PF), role functioning (RF), and Global Health Status/quality of life (GHS/QoL), defined as the time from randomization to the first documentation of a ≥10 point decrease from baseline in the EORTC QLQ-C30 linearly transformed PF scale score, RF scale score, or GHS/QoL scale score, respectively, held for 2 consecutive timepoints, or a ≥10-point decrease followed by death attributable to cancer progression with 28 days from the last assessment., Tumor-response endpoints defined as above but assessed according to iRECIST (ie, iPFS, iORR, iDOR, iCBR, and iPFS rate at 6 and 12 months)., TTD in the pain and swallowing multi-item scales of the QLQ H&N35., Mean scores and mean change from baseline scores in function (physical, role, cognitive, emotional, and social), GHS/QoL, and disease-and treatment-related symptoms, as assessed through use of the EORTC QLQ C30 and QLQ-H&N35 and EQ-5D-5L scales at specified timepoints., Presence, frequency of occurrence, severity, and/or degree of interference with daily function of selected symptomatic treatment toxicities (ie, nausea, diarrhea, fatigue, rash, itching), as assessed through use of the NCI PRO CTCAE., INBRX-106 concentration at prespecified timepoints and PK parameters such as Cmax, Ctrough, AUC, Vd, CL, and t1/2, as the data permit., Incidence of ADAs and neutralizing antibodies against INBRX-106., Relationship between biomarkers in blood, plasma, serum, PBMCs, and/or tumor tissue with efficacy, safety, PK, disease biology, or other biomarker endpoints.

Source: https://euclinicaltrials.eu/ctis-public/view/2024-515538-34-00